EU clinical trial 2024-517625-72-00: An open label, balanced, randomized, two-treatment, two-period, two-sequence, single-dose, crossover, bioequivalence study comparing Tamsulosin Hydrochloride Capsules USP 0.4 mg, manufactured by Sun Pharmaceutical Industries Limited, India with Tamsulosin Hydrochloride extended-release capsules 0.4 mg, Product of Geolab Indústria Farmacêutica S/A, VP. 1B QD.08-B Modules 01 to 08, DAIA - Anápolis – GO, in healthy adult, human male subjects under fasting condition.
Protocol code: TAMSU-12-24
Sponsor: Sun Pharmaceutical Industries Limited (Pharmaceutical company). Phase: Human Pharmacology (Phase I)- Bioequivalence Study. Countries: Romania (ended).
Therapeutic area(s): Diseases [C] - Male Urogenital Diseases [C12]
Gender: Male. Age: 18-64 years. Enrolment: 72.
Status: Ended. Start date (EU): 2025-10-16. End date (EU): 2025-12-05. Decision date: 2025-06-16. Results received: No. Last updated: 2025-06-16.

Condition(s): Benign prostatic hyperplasia (BPH)

Source: https://euclinicaltrials.eu/ctis-public/view/2024-517625-72-00